EU clinical trial 2024-515820-35-02: Sleep structure in neuropathic pain patients, psychological factors, brain connectivity, and the effect of pregabalin on sleep and pain
Protocol code: 2024-515820-35-00
Sponsor: HUS-Yhtymae (Hospital/Clinic/Other health care facility). Phase: Therapeutic use (Phase IV). Countries: Finland (authorised, recruitment pending).
Therapeutic area(s): Diseases [C] - Nervous System Diseases [C10]
Gender: Female, Male. Age: 18-64 years, 65+ years. Enrolment: 40.
Status: Authorised, recruitment pending. Decision date: 2024-11-14. Results received: No. Last updated: 2024-11-14.

Condition(s): Patients have peristent peripheral neuropathic pain. They are not rare diseases.
Product: Pregabalin Pfizer 150 mg hard capsules, Lyrica 25 mg hard capsules, Lyrica 75 mg hard capsules

Primary endpoint: Pregabalin response to pain. Pain intensity and interference assessed by numeric rating scale
Endpoint(s): Pregabalin effect on sleep stages. 1-night Ambulatory Polysomnography (NREM stage III)., Sleep disturbance associations to brain network connectivity. Brain fMRI for brain network connectivity, Sleep disturbance associations to choroid plexus volume in brain fMRI. Brain fMRI for choroid plexus volume measures, Pregabalin effect on circadian rhythms. 1-week actigraphy and OURA-ring, Pregabalin effect on body temperature during sleep. 1-night body temperature measurement by iButton

Source: https://euclinicaltrials.eu/ctis-public/view/2024-515820-35-02